EU clinical trial 2024-512188-29-00: A Phase IIb, prospective, intra-patient randomised controlled, multicentre study to evaluate the safety and efficacy of an autologous bio-engineered dermo-epidermal skin substitute (EHSG-KF) for the treatment of partial deep dermal and full thickness burns in adults and adolescents in comparison to autologous split-thickness skin grafts (STSG) (BA)
Protocol code: TBRU-dS-BA-PIIb
Sponsor: Cutiss AG (Pharmaceutical company). Phase: Therapeutic exploratory (Phase II). Countries: Netherlands (ended).
Therapeutic area(s): Diseases [C] - Skin and Connective Tissue Diseases [C17]
Gender: Female, Male. Age: 0-17 years, 18-64 years, 65+ years. Enrolment: 6.
Status: Ended. Start date (EU): 2020-01-20. End date (EU): 2025-09-12. End date: 2025-09-13. Decision date: 2024-10-29. Results received: Yes. Last updated: 2025-06-02.

Condition(s): Adults and adolescents with partial deep dermal and full thickness burns
Product: EHSG-KF

Primary endpoint: Efficacy evaluation, as a comparison between the EHSG-KF and control sites, based on: • Ratio of covered surface area to biopsy site/donor site surface area at visit 6 (28 +/-3 days post grafting)
Endpoint(s): % Epithelialization at: o visit 8 (90 ± 5 days post grafting), Safety and efficacy evaluation, as a comparison between the EHSG-KF and control sites, based on: secondary endpoints 3-6, - Main secondary safety endpoint: Clinical and microbiologic signs of infection at visit 4 (6-10 days post grafting) and visit 5 (21 ± 2 days post grafting), - Main secondary efficacy endpoints: Scar quality at the study areas o Assessment of elasticity of the study areas using the Cutometer® at visit 10 (1 year ± 30 days post grafting) o Assessment of general scar quality at the study areas using the POSAS, a reliable and validated scar assessment tool, at: visit 10 (1 year ± 30 days post grafting), - Other secondary safety endpoint: Assessment and reporting of all observed adverse events will be carried out for the full duration of the study from visit 2 on., - Other secondary efficacy endpoint: Epithelialization at: o visit 6 (28 ± 3 days post grafting)

Source: https://euclinicaltrials.eu/ctis-public/view/2024-512188-29-00